EU clinical trial 2024-515238-34-00: Bioequivalence clinical trial of dapagliflozin 10 mg tablets, after a single oral dose administration to healthy volunteers under fasting conditions.
Protocol code: UECHUP-DAP/24-4
Sponsor: Laboratorios Alter S.A. (Pharmaceutical company). Phase: Human Pharmacology (Phase I)- Bioequivalence Study. Countries: Spain (ended).
Therapeutic area(s): Diseases [C] - Nutritional and Metabolic Diseases [C18]
Gender: Female, Male. Age: 18-64 years. Enrolment: 30.
Status: Ended. Start date (EU): 2024-10-10. End date (EU): 2024-11-05. Decision date: 2024-09-23. Results received: No. Last updated: 2024-09-23.

Condition(s): Diabetes

Source: https://euclinicaltrials.eu/ctis-public/view/2024-515238-34-00